EU clinical trial 2025-523018-10-00: Evaluation of a New Pain Management Regime for Oocyte Pick-Up During Fertility Treatment
Sponsor: UZ Brussel (Hospital/Clinic/Other health care facility). Phase: Phase III and phase IV (Integrated). Countries: Belgium (authorised, recruitment pending).
Therapeutic area(s): Analytical, Diagnostic and Therapeutic Techniques and Equipment [E] - Anesthesia and Analgesia [E03]
Gender: Female. Age: 18-64 years. Enrolment: 318.
Status: Authorised, recruitment pending. Decision date: 2026-01-22. Results received: No. Last updated: 2026-03-02.
Decision dates by country: BE: 2026-03-02

Condition(s): Acute procedural pain associated with oocyte pick-up (oocyte retrieval) in women undergoing IVF/ART.
Product: XANAX 0,5 mg Tabletten, Voltaren Retard 75 mg tabletten met verlengde afgifte., Midazolam Viatris 5 mg/ml oplossing voor injectie, Dzuveo 30 micrograms sublingual tablet, Linisol 2 % oplossing voor injectie, DAFALGAN FORTE 1 g filmomhulde tabletten

Primary endpoint: Overall intra-procedural pain intensity during OPU, VAS 0–100 mm recorded every 2 minutes from first puncture to completion; primary derived measure (mean/median or VAS-AUC over time) per SAP.
Endpoint(s): Patient satisfaction with pain management at ~24 h post-OPU using APS-POQ-R., Post-OPU VAS pain at T0 (arrival in recovery), 30 min, 1 h, and discharge., Rescue analgesic use at home within 24 h (type/amount)., Nausea/vomiting incidence: pre-OPU, immediate post-OPU, 30 min, 1 h, discharge, and at 24 h., Respiratory depression/other AEs during and immediately after OPU (SpO₂, RR, clinical observation)., Vaginal bleeding (usual/less/more than usual)., Recovery metrics: time to discharge, procedure duration, number of oocytes retrieved, operator experience level., Hormonal/fertility markers: E2/FSH/LH/progesterone and follicle count (2 days pre-OPU); HCG 2 weeks post-ET; clinical pregnancy at ~7 weeks.

Source: https://euclinicaltrials.eu/ctis-public/view/2025-523018-10-00